EU clinical trial 2023-504709-35-00: A Study to Evaluate the Safety, Pharmacokinetics, and Activity of Enzelkitug as a Single Agent and in Combination with Checkpoint Inhibitor in Participants With Locally Advanced or Metastatic Solid Tumors
Protocol code: GO43860
Sponsor: Genentech Inc. (Pharmaceutical company). Phase: Human Pharmacology (Phase I)- First administration to humans. Countries: Belgium (ongoing, recruitment ended), Netherlands (ongoing, recruitment ended), Spain (ongoing, recruitment ended), Greece (ongoing, recruitment ended), Sweden (ongoing, recruitment ended).
Therapeutic area(s): Diseases [C] - Neoplasms [C04]
Gender: Female, Male. Age: 18-64 years, 65+ years. Enrolment: 44.
Status: Ongoing, recruitment ended. Start date (EU): 2023-08-16. Decision date: 2024-01-15. Results received: No. Last updated: 2026-08-06.
Decision dates by country: NL: 2024-01-18, SE: 2025-06-02, BE: 2024-01-15, GR: 2025-05-16, ES: 2024-02-20

Condition(s): Locally advanced or metastatic solid tumors

Source: https://euclinicaltrials.eu/ctis-public/view/2023-504709-35-00